EU clinical trial 2024-517380-22-00: A phase 2, open label study to evaluate safety and clinical activity of balstilimab in monotherapy in patients with advanced/metastatic non-melanoma skin cancers (AGENONMELA).
Protocol code: AGENONMELA
Sponsor: Narodowy Instytut Onkologii Im. Marii Sklodowskiej-Curie Panstwowy Instytut Badawczy (Hospital/Clinic/Other health care facility). Phase: Therapeutic exploratory (Phase II). Countries: Poland (ongoing, recruitment ended).
Therapeutic area(s): Diseases [C] - Neoplasms [C04]; Diseases [C] - Skin and Connective Tissue Diseases [C17]
Gender: Female, Male. Age: 18-64 years, 65+ years. Enrolment: 39.
Status: Ongoing, recruitment ended. Start date (EU): 2021-06-18. Decision date: 2024-11-11. Results received: No. Last updated: 2026-04-13.

Condition(s): Advanced basal cell carcinoma not amenable to local therapy or after progression on at least one line of systemic therapy Advanced squamous cell carcinoma (basosquamous/metatypicus type) or other skin cancers not amenable to local therapy
Product: Balstilimab

Primary endpoint: Clinical benefit rate (CBR), defined as a stable disease (SD; partial response (PR) or complete response (CR) as determined by the investigator according to criteria –RECIST 1.1
Endpoint(s): Clinical benefit rate (CBR), defined as a stable disease (SD; partial response (PR) or complete response (CR) on two consecutive examinations >= 4 weeks apart, as determined by the investigator according to criteria ir - RECIST, Duration of Response (DoR), Progression free/Overall survival rate at 12 and 24 month, Incidence of and severity of AEs according to scale NCI CTCAE v 5.0. Changes in vital signs, physical findings, ECG/ECHO parameters, and clinical laboratory results, Change from day 1 in patient-reported outcomes (QLQ): : QLQ-C30, EQ-5D-3L, FACT-ICM, In patients +65 year old, Comprehensive Geriatric Assessment (CGA) will be performed at screening (SCR) and end of treatment (EOT)

Source: https://euclinicaltrials.eu/ctis-public/view/2024-517380-22-00